EU clinical trial 2024-520165-32-00: A Phase 3, Randomized, Double-blind, Placebo-controlled, Study to Evaluate the Efficacy and Safety of KarXT for the Treatment of Manic Episodes in Bipolar-I Disorder (BALSAM-1)
Protocol code: CN012-0036
Sponsor: Bristol-Myers Squibb Services Unlimited Company (Pharmaceutical company). Phase: Therapeutic confirmatory (Phase III). Countries: Hungary (ongoing, recruiting), Bulgaria (ongoing, recruiting), Poland (ongoing, recruiting).
Therapeutic area(s): Psychiatry and Psychology [F] - Mental Disorders [F03]
Gender: Female, Male. Age: 18-64 years. Enrolment: 77.
Status: Ongoing, recruiting. Start date (EU): 2025-11-04. Decision date: 2025-08-21. Results received: No. Last updated: 2026-04-07.
Decision dates by country: HU: 2025-08-21, BG: 2025-08-21, PL: 2025-08-26

Condition(s): BP-I mania or mania with mixed features
Product: KarXT, KarXT, KarXT, Karxt Matching Placebo

Primary endpoint: Change from baseline in Young Mania Rating Scale (YMRS, used to evaluate manic symptoms) score at Week 3.
Endpoint(s): Change from baseline in CGI-BP (used to evaluate daily functioning) at Week 3., Occurrence of TEAEs, SAEs, and TEAEs leading to treatment discontinuation and change in C-SSRS responses during the treatment period., Change from baseline in BARS, SAS, AIMS, and IPSS (males aged ≥ 45 years only) at Week 3.

Source: https://euclinicaltrials.eu/ctis-public/view/2024-520165-32-00